EU clinical trial 2023-509659-15-00: A multi-centre, four-arm, randomised, double-blind study assessing the dose equivalence of bevacizumab in first-line therapy for ovarian cancer
Protocol code: 2023/ABM/01/00015
Sponsor: Uniwersytet Medyczny W Lublinie (Educational Institution). Phase: Therapeutic use (Phase IV). Countries: Poland (authorised, recruitment pending).
Therapeutic area(s): Not possible to specify
Gender: Female. Age: 18-64 years, 65+ years. Enrolment: 332.
Status: Authorised, recruitment pending. Decision date: 2024-07-15. Results received: No. Last updated: 2024-07-15.

Condition(s): Patients with ovarian cancer, fallopian tube cancer, peritoneal carcinoma
Product: OLAPARIB, OLAPARIB, CARBOPLATIN, BEVACIZUMAB, PACLITAXEL, BEVACIZUMAB

Primary endpoint: Objective Response Rate (ORR) to treatment, defined as the proportion of patients with a complete or partial response to treatment according to response evaluation criteria in solid tumors (RECIST v.1.1) within 4 weeks after the completion of the adjuvant treatment phase., Progression-free survival (PFS), defined as the time from randomization to disease progression/recurrence according to response evaluation criteria in solid tumors (RECIST v.1.1) or all-cause death, whichever comes first.
Endpoint(s): Frequency of adverse events (AE)., Frequency of serious adverse events (SAE)., Frequency of adverse events of special interest (AESI)., Death from any cause, ORR based on best overall response (BOR) over the entire treatment period according to RECIST v.1.1, Time from start of first-line chemotherapy to start of first subsequent therapy (TFST), An analysis of the study participant's quality of life will be made on the basis of: - the standardised quality of life questionnaires QLQ-C30 and QLQ-OV28 of the European Organisation for Research and Treatment of Cancer

Source: https://euclinicaltrials.eu/ctis-public/view/2023-509659-15-00